EU clinical trial 2024-510727-19-00: A Phase 2, Multicenter, Open-Label Extension (OLE) Study to Observe the Long-Term Efficacy, Safety, and Tolerability of Repeated Administration of Upadacitinib (ABT-494) in Subjects with Crohn's Disease
Protocol code: M14-327
Sponsor: AbbVie Deutschland GmbH & Co. KG (Pharmaceutical company). Phase: Therapeutic exploratory (Phase II). Countries: Slovakia (ended), Netherlands (ended), France (ended), Germany (ended), Poland (ended), Denmark (ended).
Therapeutic area(s): Diseases [C] - Digestive System Diseases [C06]
Gender: Female, Male. Age: 18-64 years, 65+ years. Enrolment: 12.
Status: Ended. Start date (EU): 2016-10-11. End date (EU): 2025-07-15. End date: 2025-07-18. Decision date: 2024-06-24. Results received: Yes. Last updated: 2025-07-28.
Decision dates by country: DK: 2024-06-25, FR: 2024-06-26, DE: 2024-06-26, SK: 2024-06-24, NL: 2024-06-25, PL: 2024-07-01

Condition(s): Crohn's Disease (CD)
Product: Upadacitinib, Upadacitinib

Primary endpoint: Proportion of subjects achieving Remission at Week 0 (Week 52 of Study M13-740), Months 12, 24, 36, 48, 60, 72, 84, and 96, Proportion of subjects in Remission at Week 0 who maintain remission at Months 12, 24, 36, 48, 60, 72, 84, and 96, Proportion of subjects achieving Response at Week 0 (Week 52 of Study M13-740), Months 12, 24, 36, 48, 60, 72, 84, and 96, Proportion of subjects achieving Clinical Remission over time, Proportion of subjects achieving modified Clinical Remission over time, Proportion of subjects achieving enhanced Clinical Response over time, Proportion of subjects achieving Clinical Response over time, Proportion of subjects achieving Endoscopic Remission at Week 0 (Week 52 of Study M13-740), Months 12, 24, 36, 48, 60, 72, 84, and 96, Proportion of subjects in Endoscopic Remission at Week 0 who maintain Endoscopic Remission at Months 12, 24, 36, 48, 60, 72, 84, and 96, Proportion of subjects achieving Endoscopic improvement at Week 0 (Week 52 of Study M13-740), Months 12, 24, 36, 48, 60, 72, 84, and 96, Proportion of subjects achieving Endoscopic Response at Week 0 (Week 52 of Study M13-740), Months 12, 24, 36, 48, 60, 72, 84, and 96, Proportion of subjects achieving Crohn's Disease Activity Index (CDAI) remission over time, Proportion of subjects achieving CDAI response over time, Proportion of subjects achieving Enhanced CDAI response over time, Proportion of subjects achieving Inflammatory Bowel Disease Questionnaire (IBDQ) remission over time, Proportion of subjects achieving IBDQ response over time, Proportion of subjects taking steroids at Baseline (of Study M13-740) who are steroid-free over time, Proportion of subjects taking steroids at Baseline (of Study M13-740) who are steroid-free for at least 90 days over time and achieve Remission, Proportion of subjects achieving Remission and normal C-reactive protein on Months 12, 24, 36, 48, 60, 72, 84, and 96
Endpoint(s): Time to dose escalation, Proportion of subjects who require dose escalation to upadacitinib 30 mg QD during this study, Change from Baseline (of Study M13-740) in the average daily very soft/liquid stool frequency at every visit, Change from Baseline (of Study M13-740) in average daily abdominal pain at every visit, Change from Baseline (of Study M13-740) in CDAI at every visit, Change from Baseline (of Study M13-740) in hs-CRP at every visit, Change from Baseline (of Study M13-740) in fecal calprotectin at every visit., Change from Baseline (of Study M13-740) in Simple Endoscopic Score for Crohn's Disease at Week 0 (Week 52 of Study M13-740), Months 12, 24, 36, 48, 60, 72, 84, and 96, Proportion of subjects in Remission, and hs-CRP < 5 mg/L, and fecal calprotectin < 250 μg/g at Week 0 (Week 52 of Study M13-740), Months 12, 24, 36, 48, 60, 72, 84, and 96, Proportion of subjects who were taking corticosteroids at Week 0 of Study M13-740 who discontinue corticosteroid use and achieved Remission over time., Change from Baseline of Study M13-740 in IBDQ over time, Change from Baseline of Study M13-740 in EuroQol Dimensions 5 Levels over time, Change from Baseline of Study M13-740 in Work Productivity and Impairment Questionnaire (WPAI) over time, Proportion of subjects with CD-related hospitalization, Proportion of subjects with CD-related surgeries and procedures, The proportion of subjects with no draining fistulas over time, Changes in extraintestinal manifestations over time., For analyses purposes, the baseline data for each subject will be the data collected immediately prior to starting double-blind-treatment of Study M13-740.

Source: https://euclinicaltrials.eu/ctis-public/view/2024-510727-19-00